EU clinical trial 2024-512345-16-00: A Phase 2, multicenter, open-label, non-randomized, proof-of-concept study evaluating the efficacy, safety, and tolerability of SAR445088 in adults with chronic inflammatory demyelinating polyneuropathy (CIDP)
Protocol code: PDY16744
Sponsor: Sanofi-Aventis Recherche & Developpement (Pharmaceutical company). Phase: Therapeutic exploratory (Phase II). Countries: Poland (ended), Germany (ended), France (ended), Spain (ended), Italy (ended), Netherlands (ended).
Therapeutic area(s): Diseases [C] - Nervous System Diseases [C10]
Gender: Female, Male. Age: 18-64 years, 65+ years. Enrolment: 56.
Status: Ended. Start date (EU): 2021-10-13. End date (EU): 2025-10-01. End date: 2025-10-02. Decision date: 2024-06-24. Results received: No. Last updated: 2025-08-14.
Decision dates by country: FR: 2024-06-24, DE: 2024-06-26, ES: 2024-06-26, NL: 2024-06-25, PL: 2024-07-23, IT: 2024-07-01

Condition(s): Chronic inflammatory demyelinating polyradiculoneuropathy
Product: riliprubart

Primary endpoint: Part A, SOC-Treated: Percentage of participants relapsing after withdrawal of SOC and during the SAR445088 treatment period, Part A, SOC-Refractory (initial and low dose group) and SOC-Naïve: Percentage of participants responding during the SAR445088 treatment period, Part B: Number of participants reported with adverse events
Endpoint(s): Part A: Number of participants reported with adverse events, Part A: Number of participants with incidence and titer of anti-SAR445088 antibodies (ADA), Part A: Percentage of participants in the SOC-Treated group improving during the overlap treatment period, Part B, SOC-Treated (initial dose group): Percentage of participants relapse-free during the treatment extension period, Part B, SOC-Refractory (initial and low dose group) and SOC-Naive: Percentage of participants with sustained response during the treatment extension period, Part B: Long-term immunogenicity

Source: https://euclinicaltrials.eu/ctis-public/view/2024-512345-16-00